EU clinical trial 2025-524122-18-00: ADRESS : Efficacy of the Alpha 2 agonist dexmedetomidine for sympathetic Deactivation in REfractory Septic Shock: a randomized, controlled trial
Protocol code: 69HCL25 0485
Sponsor: Hospices Civils De Lyon (Hospital/Clinic/Other health care facility). Phase: Therapeutic confirmatory (Phase III). Countries: France (authorised, recruitment pending).
Therapeutic area(s): Not possible to specify
Gender: Female, Male. Age: 18-64 years, 65+ years. Enrolment: 360.
Status: Authorised, recruitment pending. Decision date: 2026-04-24. Results received: No. Last updated: 2026-06-29.
Decision dates by country: FR: 2026-04-29

Condition(s): Septic shock
Product: DEXMÉDÉTOMIDINE VIATRIS 100 microgrammes/mL, solution à diluer pour perfusion, NOREPINEPHRINE, MIDAZOLAM, HYDROCORTISONE, PROPOFOL

Primary endpoint: Vital status at 30 days after randomization (Day 30).
Endpoint(s): Efficacy criteria: Vital status at 72 hours after randomization., Efficacy criteria: Cumulative dose and peak of vasopressors in norepinephrine equivalent (NEE score, Kotani et al. 2023) at 6h, 12h, and 24h after randomization., Efficacy criteria: Rate of use of vasopressin (VP) or other rescue therapies during the 30 days following randomization (Day 0 → Day 30)., Efficacy criteria: Evolution of mean arterial pressure (MAP) and MAP/Neq ratio (Neq = norepinephrine equivalent) within the first 24 hours after randomization (H0, H+6, H+12, H+24)., Efficacy criteria: Number of vasopressor-free days during the 30 days following randomization (Day 0 → Day 30)., Efficacy criteria: Number of mechanical ventilation–free days during the 30 days following randomization (Day 0 → Day 30)., Efficacy Criteria: Lactate level at randomization, then at H+6, H+12, and H+24., Efficacy Criteria: SOFA score at Day 0 and Day 3 after randomization., Efficacy Criteria: Difference between total fluid intake (including IV infusions, enteral nutrition, blood products, flushes, and diluents) and total fluid losses (including urine output, drain outputs, and gastric tube losses) over 6 days (from Day 0 to Day 5)., Efficacy Criteria: Occurrence of new-onset or persistent atrial fibrillation within 14 days following randomization., Efficacy Criteria: Vital status at ICU discharge and at 90 days after randomization., Tolerance Criteria: Occurrence of bradycardia during the treatment period: heart rate (HR) < 50 bpm requiring therapeutic intervention (discontinuation of dexmedetomidine due to bradycardia, administration of atropine, adrenaline, isoprenaline, or external electrical pacing)., Tolerance Criteria: Number of coma-free days at Day 30 (or at ICU discharge if discharged before Day 30), defined as the number of days with a RASS score ≥ -3., Tolerance Criteria: Occurrence of ICU delirium during the stay, screened daily using the CAM-ICU score (Appendix 2) until Day 30 (or ICU discharge if discharged before Day 30) in patients with a RASS score (Appendix 2) ≥ -3., Ancillary Study Criteria: Serum electrolyte panel (Na⁺, K⁺, Cl⁻) at H0 (randomization), H+12, H+24, H+48, and Day 5; plasma measurements of endogenous catecholamines and plasma assays of the renin–angiotensin system (angiotensin I and II, aldosterone) at H0 (randomization), H+12, H+48, and Day 5. Urinary electrolyte panel (Na⁺, K⁺, Cl⁻) and urinary measurements of endogenous catecholamines and the renin–angiotensin system (angiotensin I and II, aldosterone) at H+24.

Source: https://euclinicaltrials.eu/ctis-public/view/2025-524122-18-00